EU clinical trial 2023-507192-22-00: ION440-CS1: A Phase 1-2, Double-Blind, Sham-Controlled Multiple Ascending Dose Study to Evaluate Safety, Tolerability, Pharmacokinetics, and Pharmacodynamics of Intrathecally-Administered ION440 in Patients with MECP2 Duplication Syndrome
Protocol code: ION440-CS1
Sponsor: Ionis Pharmaceuticals Inc. (Pharmaceutical company). Phase: Phase I and Phase II (Integrated)- First administration to humans. Countries: Spain (ongoing, recruiting), France (ongoing, recruiting), Austria (ongoing, recruiting).
Therapeutic area(s): Phenomena and Processes [G] - Genetic Phenomena [G05]
Gender: Male. Age: 0-17 years, 18-64 years, 65+ years. Enrolment: 16.
Status: Ongoing, recruiting. Start date (EU): 2025-10-24. Decision date: 2024-07-23. Results received: No. Last updated: 2026-06-03.
Decision dates by country: ES: 2024-07-23, FR: 2024-07-25, AT: 2025-07-14

Condition(s): Methyl CpG binding protein 2 (MECP2) Duplication Syndrome (MDS)
Product: ION440

Primary endpoint: Incidence of treatment-emergent adverse events (TEAEs) and clinically significant change from Baseline (BL) in vital signs, physical and neurological examination, laboratory assessments, and electrocardiogram (ECG) over the course of the study.
Endpoint(s): Maximum plasma concentration (Cmax), area under the concentration-time curve (AUC), elimination half-life (t½), and trough (pre-dose) and post-treatment ION440 concentrations, where appropriate, ION440 trough (pre-dose) and post-treatment concentrations in CSF

Source: https://euclinicaltrials.eu/ctis-public/view/2023-507192-22-00